EU clinical trial 2023-509384-25-00: An Exploratory Phase 1b/2a Multicenter, Open-Label, Novel-Novel Combination Study to Assess the Safety, Pharmacokinetics, Pharmacodynamics, and Preliminary Efficacy of CC-92480 (BMS-986348) in Novel Therapeutic Combinations in Participants with Relapsed or Refractory Multiple Myeloma
Protocol code: CA057-003
Sponsor: Celgene Corp. (Pharmaceutical company). Phase: Phase I and Phase II (Integrated)- Other. Countries: Spain (ongoing, recruiting), Norway (ongoing, recruiting).
Therapeutic area(s): Diseases [C] - Neoplasms [C04]
Gender: Female, Male. Age: 18-64 years, 65+ years. Enrolment: 56.
Status: Ongoing, recruiting. Start date (EU): 2022-12-30. Decision date: 2024-05-16. Results received: No. Last updated: 2026-08-07.
Decision dates by country: ES: 2024-05-16, NO: 2024-05-22

Condition(s): Relapsed or Refractory Multiple Myeloma (RRMM)
Product: TAZEMETOSTAT, Mekinist 2 mg film-coated tablets, CC-92480, CC-92480, CC-92480, Mekinist 0.5 mg film-coated tablets, CC-92480, Dexamethason 4 mg GALEN®, CC-92480, Dexamethason 4 mg JENAPHARM®, Dexamethason-ratiopharm® 4 mg Tabletten, CC-92480, BET-Inhibitor

Primary endpoint: Safety : Type, frequency, seriousness, and severity of adverse events (AEs), and relationship of AEs to study treatment., Recommended Phase 2 Dose (RP2D): Establish the RP2D for CC-92480 in each novel treatment combination with dexamethasone.
Endpoint(s): Overall Response Rate (ORR) : Best response ≥ partial response (PR), according to the International Myeloma Working Group (IMWG) Uniform Response Criteria89, Complete Response Rate (CRR): Percentage of participants who achieved ≥ complete response (CR), according to IMWG Uniform Response Criteria, Very Good Partial Response Rate (VGPRR) : Percentage of participants who achieved ≥ VGPR, according to IMWG Response Criteria, Progression-Free Survival (PFS) : Time from enrollment to the first documentation of progressive disease (PD) or death from any cause during study, whichever occurs earlier, Time-to-Response (TTR) : Time from first dose to the first documentation of response (≥ PR), Duration of Response (DOR) : Time from the first documentation of response (≥ PR) to the first documentation of PD or death

Source: https://euclinicaltrials.eu/ctis-public/view/2023-509384-25-00